EU clinical trial 2023-509300-14-00: Double-Blind, Placebo-Controlled, Phase 3 Study to Evaluate the Efficacy and Safety of Plozasiran in Adults with Severe Hypertriglyceridemia (SHASTA-3 Study)
Protocol code: AROAPOC3-3003
Sponsor: Arrowhead Pharmaceuticals Inc. (Pharmaceutical company). Phase: Therapeutic confirmatory (Phase III). Countries: Poland (ongoing, recruitment ended), Belgium (ended), Czechia (ongoing, recruitment ended), Spain (ended), Slovakia (ended), Croatia (ended), Italy (ended), Hungary (ended), Bulgaria (ongoing, recruitment ended), Romania (ended).
Therapeutic area(s): Diseases [C] - Nutritional and Metabolic Diseases [C18]
Gender: Female, Male. Age: 18-64 years, 65+ years. Enrolment: 169.
Start date (EU): 2024-10-31. Decision date: 2024-09-23. Results received: No. Last updated: 2026-05-28.
Decision dates by country: RO: 2024-09-30, ES: 2024-09-27, IT: 2024-09-26, CZ: 2024-09-25, HR: 2024-09-25, PL: 2024-09-30, BE: 2024-09-25, SK: 2024-09-23, HU: 2024-09-30, BG: 2024-09-30

Condition(s): Severe hypertriglyceridemia (SHTG)
Product: Plozasiran Injection Placebo, ARO-APOC3 PFS

Primary endpoint: Percent change in fasting serum TG levels from baseline to Month 12 (V10 and V11) compared to placebo
Endpoint(s): Percent change in fasting serum TG levels from baseline to Month 10 (V8 and V9) compared to placebo, Proportion of subjects who achieve fasting TG levels of <500 mg/dL (<5.65 mmol/L) at Month 12 (V10 and V11) compared to placebo, Proportion of subjects who achieve fasting TG levels of <150 mg/dL (<1.69 mmol/L) at Month 12 (V10 and V11) compared to placebo, Percent change in remnant cholesterol (VLDL-C) from baseline to Month 12 (V11) compared to placebo, Percent change in non-HDL-C from baseline to Month 12 (V11) compared to placebo, Adjudicated AP event rate during the treatment period compared to placebo from day 1 to at Month 12 (V11)

Source: https://euclinicaltrials.eu/ctis-public/view/2023-509300-14-00